EU clinical trial 2023-504063-17-00: A Phase 1 Study of JNJ-87189401 Combined with JNJ-78278343 for Advanced Prostate Cancer
Protocol code: 87189401PCR1001
Sponsor: Janssen - Cilag International (Pharmaceutical company). Phase: Human Pharmacology (Phase I)- First administration to humans. Countries: Netherlands (not authorised), France (ongoing, recruiting).
Therapeutic area(s): Diseases [C] - Neoplasms [C04]
Gender: Male. Age: 18-64 years, 65+ years. Enrolment: 71.
Start date (EU): 2024-03-08. Decision date: 2024-02-23. Results received: No. Last updated: 2026-06-02.
Decision dates by country: NL: 2024-02-23, FR: 2024-06-10

Condition(s): Advanced Prostate Cancer

Source: https://euclinicaltrials.eu/ctis-public/view/2023-504063-17-00